EU clinical trial 2023-506108-23-00: A trial to learn how baxdrostat affects the heartbeat in healthy participants
Protocol code: D6970C00004
Sponsor: Astrazeneca AB (Pharmaceutical company). Phase: Human Pharmacology (Phase I)- Other. Countries: Germany (ended).
Therapeutic area(s): Diseases [C] - Cardiovascular Diseases [C14]
Gender: Female, Male. Age: 18-64 years. Enrolment: 28.
Status: Ended. Start date (EU): 2024-02-06. End date (EU): 2024-05-13. Decision date: 2024-01-30. Results received: No. Last updated: 2024-04-24.
Decision dates by country: DE: 2024-03-29

Condition(s): Treatment-resistant hypertension, Primary aldosteronism, Uncontrolled hypertension

Source: https://euclinicaltrials.eu/ctis-public/view/2023-506108-23-00